EU clinical trial 2024-511096-15-00: A randomised, double-blind, parallel group, placebo-controlled multi-centre Phase III study to assess the efficacy and safety of olaparib versus placebo as adjuvant treatment in patients with germline BRCA1/2 mutations and high risk HER2 negative primary breast cancer who have completed definitive local treatment and neoadjuvant or adjuvant chemotherapy.
Protocol code: D081CC00006
Sponsor: AstraZeneca AB (Pharmaceutical company). Phase: Therapeutic confirmatory (Phase III). Countries: Spain (ongoing, recruitment ended), Iceland (ongoing, recruitment ended), Sweden (ongoing, recruitment ended), Netherlands (ongoing, recruitment ended), Poland (ongoing, recruitment ended), Germany (ongoing, recruitment ended), Belgium (ongoing, recruitment ended), Hungary (ongoing, recruitment ended), France (ongoing, recruitment ended), Portugal (ongoing, recruitment ended), Italy (ongoing, recruitment ended), Austria (ongoing, recruitment ended).
Therapeutic area(s): Diseases [C] - Neoplasms [C04]
Gender: Female, Male. Age: 18-64 years, 65+ years. Enrolment: 864.
Status: Ongoing, recruitment ended. Start date (EU): 2014-08-01. Decision date: 2024-03-15. Results received: No. Last updated: 2026-07-15.
Decision dates by country: SE: 2024-03-27, HU: 2024-03-16, IS: 2024-04-23, NL: 2024-04-04, BE: 2024-03-22, PL: 2024-04-15, AT: 2024-04-08, IT: 2024-03-25, DE: 2024-03-28, FR: 2024-04-25, PT: 2024-03-15, ES: 2024-03-18

Condition(s): Breast Cancer
Product: Lynparza 100 mg film-coated tablets, Placebo - film-coated tablets, Lynparza 150 mg film-coated tablets

Primary endpoint: Invasive Disease Free Survival (IDFS)
Endpoint(s): Overall survival (OS), Distant Disease Free Survival (DDFS), Incidence of new primary contralateral invasive breast cancer, primary contralateral non-invasive breast cancer, new primary ovarian cancer, new primary fallopian tube cancer and new primary peritoneal cancer, Patient Reported Outcomes from FACIT Fatigue and EORTCQLQ-C30 QoL questionnaires, Determination of BRCA mutation status using current and future BRCA mutation assays (gene sequencing and large rearrangement analysis), Exposure to olaparib (in plasma) in patients receiving olaparib as adjuvant therapy, Safety

Source: https://euclinicaltrials.eu/ctis-public/view/2024-511096-15-00